EU clinical trial 2024-511594-30-00: A Phase 3 Randomized, Open-Label, Multicenter Study Evaluating the Efficacy of Axicabtagene Ciloleucel Versus Standard of Care Therapy in Subjects with Relapsed/Refractory Follicular Lymphoma
Protocol code: KT-US-473-0133
Sponsor: Kite Pharma Inc. (Pharmaceutical company). Phase: Therapeutic confirmatory (Phase III). Countries: Italy (ongoing, recruitment ended), Spain (ongoing, recruitment ended), Germany (ongoing, recruitment ended), France (ongoing, recruitment ended).
Therapeutic area(s): Diseases [C] - Neoplasms [C04]
Gender: Female, Male. Age: 18-64 years, 65+ years. Enrolment: 142.
Status: Ongoing, recruitment ended. Start date (EU): 2023-02-23. Decision date: 2024-07-23. Results received: No. Last updated: 2026-08-03.
Decision dates by country: DE: 2024-07-23, ES: 2024-07-23, IT: 2024-08-05, FR: 2025-08-28

Condition(s): Relapsed/Refractory Follicular Lymphoma
Product: Endoxana Injection 1000 mg Powder for Solution for Injection, Doxorubicin Teva 2 mg/ml Concentrate for Solution for Infusion, Vincristine Sulfate 1 mg/ml Solution for Injection or Infusion, Prednisolone 5 mg Soluble Tablets, Revlimid 20 mg hard capsules, Bendamustine 100mg Powder for Concentrate for Solution for Infusion, MabThera 500 mg concentrate for solution for infusion, YESCARTA 0.4 – 2 x 10e8 cells dispersion for infusion

Primary endpoint: PFS, defined as the time from randomization to disease progression per the International Working Group Lugano Classification {Cheson 2014} as determined per a blinded central assessment, or death due to any cause.
Endpoint(s): OS, CR rate per Lugano Classification {Cheson 2014} as determined per a blinded central assessment, ORR (CR + PR per Lugano Classification {Cheson 2014}) as determined per a blinded central assessment, DOR, Duration of CR, EFS, TTNT, Incidence of adverse events (AEs) and clinically significant changes in safety laboratory values, Incidence of replication-competent retrovirus (RCR) detection in blood over time, Changes from baseline in the Global Health Status Quality of Life scale and the physical functioning domain of the European Organisation for Research and Treatment of Cancer Quality of Life Questionnaire-30 (EORTC QLQ-C30) and the Low Grade NonHodgkin Lymphoma-20 (NHL-LG20), Changes from baseline in the EuroQoL 5-Dimension 5-Level (EQ-5D-5L) and visual analogue scale (VAS).

Source: https://euclinicaltrials.eu/ctis-public/view/2024-511594-30-00